EU clinical trial 2025-524092-23-00: A Phase 3 prospective, randomized, multicenter, active-controlled study to evaluate the efficacy and safety of BV100 plus low-dose polymyxin B compared with colistin plus high-dose ampicillin/sulbactam in the treatment of adult patients with hospital-acquired bacterial pneumonia and ventilator-associated bacterial pneumonia caused by carbapenem-resistant Acinetobacter baumannii-calcoaceticus complex
Protocol code: BV100-010
Sponsor: Bioversys S.A.S. (Pharmaceutical company). Phase: Therapeutic confirmatory (Phase III). Countries: Greece (authorised, recruiting), Croatia (authorised, recruiting).
Therapeutic area(s): Diseases [C] - Bacterial Infections and Mycoses [C01]; Diseases [C] - Respiratory Tract Diseases [C08]
Gender: Female, Male. Age: 18-64 years, 65+ years. Enrolment: 58.
Status: Authorised, recruiting. Start date (EU): 2026-07-21. Decision date: 2026-06-10. Results received: No. Last updated: 2026-06-15.
Decision dates by country: HR: 2026-06-15, GR: 2026-06-10

Condition(s): Hospital-acquired bacterial pneumonia including ventilator-associated bacterial pneumonia caused by carbapenem-resistant Acinetobacter baumannii-calcoaceticus complex
Product: AMPICILLIN AND BETA-LACTAMASE INHIBITOR, COLISTIN, Rifabutin

Primary endpoint: 28-day ACM in the CRABC m-MITT Population in Part A
Endpoint(s): Clinical cure at ToC in the CRABC m-MITT Population, 28-day ACM in the ITT and MITT Populations, 28-day ACM in the ITT, MITT, and CRABC m-MITT Populations in VABP patients only, 14-day ACM in the MITT and CRABC m-MITT Populations, Safety will be evaluated in the Safety Population through the assessment of the following: Adverse events, Vital signs (blood pressure, heart rate, and body temperature), Clinical laboratory evaluations (chemistry, hematology, and urinalysis), Concomitant medications, Renal function, Electrocardiograms, Clinical cure at Day 3, Day 5, Day 8, EoT, ToC, and EoS in the ITT, MITT, m-MITT, CRABC m-MITT, and PP Populations in Part A; Microbiological favorable assessment at Day 3, Day 5, Day 8, EoT, ToC, and EoS in the MITT, m-MITT, and CRABC m MITT Populations in Part A, 28-day ACM in the ITT, MITT, and CRABC m-MITT Populations in Part B; Clinical cure at Day 3, Day 5, Day 8, EoT, ToC, and EoS in the MITT, m-MITT, CRABC m-MITT, and PP Populations in Part B

Source: https://euclinicaltrials.eu/ctis-public/view/2025-524092-23-00